EU clinical trial 2025-524208-31-00: Radium223 dichloride (223RaCl) in the treatment of symptomatic bone metastases from breast cancer.
Protocol code: PA IT23 2009
Sponsor: Azienda Ospedaliera Universitaria Policlinico Paolo Giaccone (Hospital/Clinic/Other health care facility). Phase: Therapeutic exploratory (Phase II). Countries: Italy (authorised, recruitment pending).
Therapeutic area(s): Diseases [C] - Neoplasms [C04]
Gender: Female. Age: 18-64 years, 65+ years. Enrolment: 50.
Status: Authorised, recruitment pending. Decision date: 2026-06-08. Results received: No. Last updated: 2026-06-08.

Condition(s): Symptomatic bone metastases from breast cancer
Product: EXEMESTANE, RADIUM (223RA) DICHLORIDE, LETROZOLE, ANASTROZOLE

Primary endpoint: PFS (progression-free survival, understood as the time between signing the informed consent to the study and documented disease progression or death from any cause), Reduction of pain from bone metastases, QOL (quality of life)
Endpoint(s): OS (Overall Survival, understood as the time between signing the informed consent to the study and death from any cause), Survival free from symptomatic skeletal events, Time to total alkaline phosphatase (ALP) progression (calculated from baseline to the first quantitative increment), Reduction in ALP value (calculated from baseline to the maximum reduction recorded during treatment/follow-up)

Source: https://euclinicaltrials.eu/ctis-public/view/2025-524208-31-00